EU clinical trial 2025-524297-42-00: Duration of Dual Anti-Platelet Therapy in Chronic Limb Threatening Ischemia after Distal Revascularization: a randomized, double-blind trial PALADIN [PeripherAL Arterial DIsease Network] -DAPTCLTI
Protocol code: PHRC-23-0035
Sponsor: Fondation Hopital Saint Joseph (Hospital/Clinic/Other health care facility). Phase: Therapeutic confirmatory (Phase III). Countries: France (ongoing, recruiting).
Therapeutic area(s): Diseases [C] - Cardiovascular Diseases [C14]
Gender: Female, Male. Age: 18-64 years, 65+ years. Enrolment: 614.
Status: Ongoing, recruiting. Start date (EU): 2026-06-12. Decision date: 2026-03-05. Results received: No. Last updated: 2026-03-05.

Condition(s): CLTI defined as Rutherford category 4 or 5
Product: Clopidogrel Viatris 75 mg film-coated tablets, LACTOSE MONOHYDRATE

Primary endpoint: Amputation-free survival at 12 months, defined as time from randomization until major amputation (defined as above-the-ankle amputation) or death from any cause, whichever occurs first, for all subjects.
Endpoint(s): Individual component of the combined primary endpoint: major amputation, overall mortality at 12 months., MALE, a combined secondary endpoint at 12 months, defined by the occurrence of either one of the following items whichever occurs first: re-intervention on the index arterial segment (Target Lesion Revascularization/TLR), acute limb ischemia, major amputation of the index limb (above-the-ankle amputation), MACE, a combined secondary endpoint at 12 months, defined by the occurrence of either of the following items whichever occurs first: myocardial infarction, stroke or cardiovascular death, Change between inclusion and 12 months in quality of life using a disease-specific QoL Questionnaire commonly used in CLTI patients (VascuQoL-6 questionnaire) and a generic one, the EQ-5D-5L questionnaire, Fatal bleeding and/or symptomatic bleeding in a critical area/organ (such as intracranial, intraspinal, intraocular, retroperitoneal, intra-articular or pericardial, or intramuscular with compartment syndrome), Bleeding causing a fall in hemoglobin level of 2 g/dL or more, Bleeding leading to transfusion of two or more units of whole blood or red cells, Requiring intervention (medical practitioner-guided medical or surgical treatment to stop or treat bleeding, including temporarily or permanently discontinuing or changing the dose of a medication or study drug),, Resulting in hospitalization or inducing an increase in the duration of hospitalization,, Prompting evaluation (leading to an unscheduled visit to a healthcare professional and diagnostic testing, either laboratory or imaging), Net clinical benefit outcome (composite outcome comprising deaths, MALE, MACE and major bleeding events), Quality of life: VascuQol-6 and EQ-5D-5L scales, Costs at 12 months, Incremental cost-effectiveness and utility ratio (ICUR)

Source: https://euclinicaltrials.eu/ctis-public/view/2025-524297-42-00